EU clinical trial 2025-521706-17-00: Phase 2, Randomized, Double-Blind, Placebo-controlled, Parallel-Group, Multicenter Study to Evaluate the Safety and Efficacy of Tarperprumig in Adult Participants with Anti-Neutrophil Cytoplasmic Antibody-Associated Vasculitis
Protocol code: ALXN1820-ANCA-201
Sponsor: Alexion Pharmaceuticals Inc. (Pharmaceutical company). Phase: Therapeutic exploratory (Phase II). Countries: Spain (ongoing, recruiting), France (ongoing, recruiting), Italy (ongoing, recruiting), Germany (ongoing, recruiting), Poland (ongoing, recruiting).
Therapeutic area(s): Diseases [C] - Hemic and Lymphatic Diseases [C15]
Gender: Female, Male. Age: 18-64 years, 65+ years. Enrolment: 21.
Status: Ongoing, recruiting. Start date (EU): 2025-11-25. Decision date: 2025-11-17. Results received: No. Last updated: 2025-12-12.
Decision dates by country: FR: 2025-11-21, PL: 2025-11-21, ES: 2025-11-20, IT: 2025-11-17, DE: 2025-11-18

Condition(s): Anti-neutrophil cytoplasmic antibody (ANCA)-associated vasculitis
Product: Tarperprumig Placebo, Tarperprumig

Primary endpoint: Incidence of TEAEs and TESAEs., Changes from Baseline in safety assessments (vital sign measurements, physical examination, clinical laboratory tests, and ECG results).
Endpoint(s): Achieving disease remission at Week 26., Achieving sustained remission at Week 52., Achieving BVAS = 0 at [CCI], 26, and 52., Relapse after previously achieving disease remission at Week 26., Time to first relapse after having achieved disease remission at Week 26., Change from Baseline in Vasculitis Damage Index (VDI) at [CCI] 26, and 52., Time to first occurrence of BVAS = 0., Change from Baseline in BVAS at all timepoints., Change from Baseline in eGFR (mL/min per 1.73 m2) at [CCI] 26, and 52., Change from Baseline in proteinuria based on spot UPCR (mg/g) and % change from Baseline at [CCI] 26, and 52., Change from Baseline in proteinuria based on spot UACR (mg/g) and % change from Baseline at [CCI] 26, and 52., Hematuria change from Baseline (RBCs/HPF) and % change from Baseline at [CCI] 26, and 52.

Source: https://euclinicaltrials.eu/ctis-public/view/2025-521706-17-00